EU clinical trial 2023-510335-11-00: Testing Insulin Enemas for Ulcerative Colitis: A First-Stage Clinical Trial
Protocol code: ET-RIT-02
Sponsor: EnteroTarget ApS (Pharmaceutical company). Phase: Human Pharmacology (Phase I)- Other. Countries: Poland (ended).
Therapeutic area(s): Diseases [C] - Digestive System Diseases [C06]
Gender: Female, Male. Age: 18-64 years. Enrolment: 6.
Status: Ended. Start date (EU): 2025-02-04. End date (EU): 2025-09-02. Decision date: 2024-09-06. Results received: No. Last updated: 2024-12-23.

Condition(s): Ulcerative colitis

Source: https://euclinicaltrials.eu/ctis-public/view/2023-510335-11-00